EU clinical trial 2022-501874-21-00: Optimized pharmacological treatment for broken heart (takotsubo) syndrome
Protocol code: BROKEN-SWEDEHEART
Sponsor: Vastra Gotalandsregionen (Hospital/Clinic/Other health care facility). Phase: Therapeutic use (Phase IV). Countries: Sweden (ongoing, recruiting), Denmark (ongoing, recruiting), Norway (ongoing, recruiting).
Therapeutic area(s): Diseases [C] - Cardiovascular Diseases [C14]
Gender: Female, Male. Age: 18-64 years, 65+ years. Enrolment: 1600.
Status: Ongoing, recruiting. Start date (EU): 2020-12-15. Decision date: 2022-11-18. Results received: No. Last updated: 2025-05-16.
Decision dates by country: DK: 2023-09-13, SE: 2022-11-18, NO: 2023-09-06

Condition(s): Takotsubo syndrome
Product: Adenosin Life Medical 5 mg/ml, Injektions-/infusionsvätska, lösning., Dipyridamol Alternova 200 mg depotkapslar, hårda, Eliquis 5 mg film-coated tablets

Primary endpoint: Randomization 1: First co-primary endpoint - Wall motion score index at 48-96 hors, Randomization 1: Second co-primary endpoint- The occurrence of the composite of death, cardiac arrest,or the need for cardiac mechanicalassist device up until day 30,or ejaction fraction less than 50% at 48-96 hours or rehospitalization for heart failure up until day 30, Randomization 2:The occurrence of any thromboembolic event(defined as ischemic stroke, peripheral arterial embolization or myocardial infarction) or death up until day 30,or the presence of a cardiac thrombus at 48-96 hours as assessed by echocardiography
Endpoint(s): The hierarchical occurrence of time to death, time to cardiac assist device, time to cardiac arrest (all time to the first occurance up until day 30), and ejaction fraction less than 50% at 48-96 hours (binary), Ejaction fraction at 48-96 hours (continuous), Any sustained ventricular tachycardia or fibrillation within 48-96 hours (binary), Any high-grade atrioventricular block or sinus arrest within 48-96 hours (binary), Need for cardiac assist device up until day 30 (binary), Death up until day 30 (binary), Stroke up until day 30 (binary), Rehospitalization for Takotsubo Syndrome at 6 months and 1-10 years, All cause mortality at 6 months and 1-10 years, Worsening heart failure in hospital up until day 30, Specific for randomization 2: cardiac thrombus at 48 - 96 hrs, Specific for randomization 2: thrombolysis in Myocardial Infarction (TIMI) bleeding criteria minor or major up until 30 days (binary), Specific for randomization 2: ejection fraction (EF) < 50% at 48 - 96 hrs (binary), Specific for randomization 2: Bleeding Academic Research Consortium (BARC) grade 2-5 up until 30 days (binary), Specific for randomization 2: any blood transfusion (binary)

Source: https://euclinicaltrials.eu/ctis-public/view/2022-501874-21-00